EU clinical trial 2023-506556-24-00: Immunomodulatory effects of dexamethasone, tocilizumab and anakinra during experimental human endotoxemia: the DEDICATE-LPS study
Protocol code: 114730
Sponsor: Stichting Radboud University Medical Center (Hospital/Clinic/Other health care facility). Phase: Therapeutic exploratory (Phase II). Countries: Netherlands (ongoing, recruitment ended).
Therapeutic area(s): Phenomena and Processes [G] - Immune system processes [G12]
Gender: Male. Age: 18-64 years. Enrolment: 52.
Status: Ongoing, recruitment ended. Start date (EU): 2024-10-24. Decision date: 2024-05-08. Results received: No. Last updated: 2025-04-28.

Condition(s): Inflammatory response following human endotoxemia in healthy volunteers
Product: Dexamethason CF 4 mg/ml, oplossing voor injectie, NaCl 0,45% + Glucose 2,5%, oplossing voor infusie, Natriumchloride 0,9 %, oplossing voor infusie 9 g/l, Atropinesulfaat Aguettant 0,1 mg/ml, oplossing voor injectie in voorgevulde spuit., RoActemra 20 mg/mL concentrate for solution for infusion, Kineret 100 mg/0.67 ml solution for injection in pre-filled syringe., Lidocaïne HCl B. Braun 10 mg/ml, oplossing voor injectie, Lipopolysaccharide from E. coli 0113

Primary endpoint: The effects of dexamethasone, tocilizumab and anakinra on the development of immunoparalysis in a repeated endotoxemia model in humans, reflected by between-group differences in plasma TNF concentrations upon the second LPS challenge.
Endpoint(s): Between-group differences in plasma cytokine concentrations during the second LPS challenge (e.g. IL1RA, IL-6, IL-8, IL-10, MIP-1α, MIP-1ß, MCP-1, G-CSF, IP-10, CX3CL1, YKL-40)., Between-group differences in the log2-fold change of the Area Under the Curves (AUCs) of plasma cytokine concentrations (e.g. TNF, IL1RA, IL-6, IL-8, IL-10, MIP-1α, MIP-1ß, MCP-1, G-CSF, IP-10, CX3CL1, YKL-40) during the first and second LPS challenges., Between-group differences in other plasma inflammatory proteins upon the second LPS challenge, as measured by the Olink Target 96 inflammation panel (92 protein biomarkers)., Between-group differences in the log2-fold change of peak plasma concentrations of other inflammatory proteins, as measured by the Olink Target 96 inflammation panel (92 protein biomarkers), during the first and second LPS challenges., Between-group differences in mHLA-DR during the first and second LPS challenge., Between-group differences in plasma cytokine concentrations during the first LPS challenge (e.g. TNF, IL1RA, IL-6, IL-8, IL-10, MIP-1α, MIP-1ß, MCP-1, G-CSF, IP-10, CX3CL1, YKL-40)., Between-group differences in other plasma inflammatory proteins upon the first LPS challenge, as measured by the Olink Target 96 inflammation panel (92 protein biomarkers)., Between-group differences in blood pressure, heart rate, temperature and symptom scores during the first LPS challenge., Within and between-group differences in blood leukocyte single cell and/or bulk mRNA profiles/transcriptomic pathways upon both LPS challenges., Within and between-group differences in cytokine production of whole blood cultures., Within and between-group differences in plasmatic coagulation parameters., Pharmacokinetic measurements (concentrations, Cmax, Tmax, AUCs, Kel and t1/2) of dexamethasone, anakinra and tocilizumab in blood upon both LPS challenges., Within and between-group differences in cytokine concentrations in saliva fluid during both LPS challenges (e.g. TNF, IL1RA, IL-6, IL-8, IL-10, MIP-1α, MIP-1ß, MCP-1, G-CSF, IP-10)., Correlation between cytokines in plasma and saliva during systemic inflammation upon both LPS challenges., Within and between-group differences in single cell and/or bulk mRNA profiles/transcriptomic pathways of cells in saliva upon both LPS challenges., Correlation of blood nitric oxide concentrations between exercise, stress and systemic inflammation., Number of adverse events related to the use of dexamethasone, tocilizumab and anakinra., Within and -between-group differences in DNA methylation profiles after 3, 6 and 12 months., Within and -between-group differences in plasma cytokine concentrations (e.g. IL1RA, IL-6, IL-8, IL-10, MIP-1α, MIP-1ß, MCP-1, G-CSF, IP-10, CX3CL1, YKL-40) after 3, 6 and 12 months., Within and -between -group differences in other plasma inflammatory proteins after 3, 6 and 12 months, as measured by the Olink Target 96 inflammation panel (92 protein biomarkers)., Within and between-group differences in blood leukocyte single cell and/or bulk mRNA profiles/transcriptomic pathways after 3, 6 and 12 months., Within and between-group differences in cytokine production of whole blood cultures after 3, 6 and 12 months.

Source: https://euclinicaltrials.eu/ctis-public/view/2023-506556-24-00